EU clinical trial 2024-514559-13-00: A Double-Blind, Randomized, Multicenter, Trial Evaluating the Efficacy and Safety of PRAX-628 in Adults with Focal Seizures (POWER 1)
Protocol code: PRAX-628-321
Sponsor: Praxis Precision Medicines Inc. (Pharmaceutical company). Phase: Phase II and Phase III (Integrated). Countries: Spain (ended), Poland (ended), Italy (ended).
Therapeutic area(s): Diseases [C] - Nervous System Diseases [C10]
Gender: Female, Male. Age: 18-64 years, 65+ years. Enrolment: 170.
Status: Ended. Start date (EU): 2024-11-26. End date (EU): 2026-04-22. End date: 2026-05-14. Decision date: 2024-10-14. Results received: No. Last updated: 2026-06-08.
Decision dates by country: PL: 2025-04-24, IT: 2025-04-17, ES: 2024-12-19

Condition(s): Focal Epilepsy
Product: PRAX-628, Placebo for PRAX-628

Primary endpoint: Median percent change in monthly (28 days) focal seizure frequency from the Screening/Observation Period to the Treatment Period for PRAX-628 compared to placebo.
Endpoint(s): Proportion of participants experiencing a ≥50% reduction in monthly (28 days) focal seizure frequency from the Screening/Observation Period to the Treatment Period (Responder Rate) for PRAX-628 compared to placebo., Number of days post-randomization to reach the same number of monthly focal seizures as the Screening/Observation Period through the end of the Treatment Period • Impact of PRAX-628 compared to placebo on PGI-S and CGI-S, Incidence and severity of TEAEs, including discontinuation of study drug due to TEAEs • Changes in vital sign measurements • Changes in clinical laboratory results • Changes in ECG parameters • Changes in suicidality, as assessed by C-SSRS, Percent change in monthly focal seizure frequency from the Screening/Observation Period to the Treatment Period for PRAX-628 compared with placebo., Proportion of participants experiencing seizure freedom, 100% reduction in monthly (28 days) focal seizure frequency from the Screening/Observation Period to the Treatment Period for PRAX-628 compared with placebo.

Source: https://euclinicaltrials.eu/ctis-public/view/2024-514559-13-00